EU clinical trial 2024-519503-10-00: An investigation of clinical outcomes and inflammatory response to heparin free extracorporeal membrane oxygenation support during clinical lung transplantation – a prospective double-blind randomised feasibility study. “Zero-Hep”
Protocol code: Zero-Hep
Sponsor: Medical University Of Vienna (Educational Institution). Phase: Therapeutic use (Phase IV). Countries: Austria (ended).
Therapeutic area(s): Not possible to specify
Gender: Female, Male. Age: 18-64 years, 65+ years. Enrolment: 80.
Status: Ended. Start date (EU): 2022-12-09. End date (EU): 2025-11-14. Decision date: 2025-01-30. Results received: No. Last updated: 2025-01-30.

Condition(s): Lung transplantation
Product: Isotone Natriumchloridlösung 0,9 % Braun Injektionslösung, Heparin Gilvasan 5000 IE/ml – Injektions-/Infusionslösung

Primary endpoint: arterial or venous thromboembolic events, circuit-related thrombosis
Endpoint(s): serious bleeding, in-house mortality rate

Source: https://euclinicaltrials.eu/ctis-public/view/2024-519503-10-00